EU clinical trial 2025-520778-20-00: EFFECTIVENESS OF SUPPLEMENTATION WITH VITAMIN D IN PATIENTS WITH DEPRESSIVE DISORDER OR BIPOLAR DISORDER: A RANDOMIZED CONTROLLED CLINICAL TRIAL
Protocol code: VIT_D_2018
Sponsor: Azienda Ospedaliera Universitaria Senese (Hospital/Clinic/Other health care facility). Phase: Phase III and phase IV (Integrated). Countries: Italy (authorised, recruitment pending).
Therapeutic area(s): Psychiatry and Psychology [F] - Mental Disorders [F03]
Gender: Female, Male. Age: 18-64 years, 65+ years. Enrolment: 150.
Status: Authorised, recruitment pending. Decision date: 2025-02-10. Results received: No. Last updated: 2025-02-10.

Condition(s): Depressive disorder, Bipolar disorder
Product: Olive oil, refined vehicle 2,5 ml (quality standard Ph. Eur. current edition monograph 1456), DIBASE 50.000 U.I./2,5 ml soluzione orale in contenitore monodose

Primary endpoint: Change in Montgomery-Asberg Depression Rating Scale - MADRS at 12 weeks of treatment, Time to remission of depressive disorder (Montgomery-Asberg Depression Rating Scale -MADRS≤ 10)
Endpoint(s): Changes in Montgomery-Asberg Depression Rating Scale (MADRS) score at 24 weeks, Changes in 25OH vitamin D levels at 12 and 24 weeks

Source: https://euclinicaltrials.eu/ctis-public/view/2025-520778-20-00